EU clinical trial 2025-524363-20-01: Phase II, Single-Center, Randomized, Double-Blind, Placebo-Controlled Clinical Trial To Evaluate The Safety And Efficacy Of Dasatinib To Reduce HIV-1 Reservoir, Chronic Inflammation, And Immune Senescence In People With HIV On Long-Term Antiretroviral Treatment.
Protocol code: DASAVIR
Sponsor: Instituto De Salud Carlos III (Laboratory/Research/Testing facility). Phase: Therapeutic exploratory (Phase II). Countries: Spain (authorised, recruitment pending).
Therapeutic area(s): Diseases [C] - Virus Diseases [C02]
Gender: Female, Male. Age: 18-64 years, 65+ years. Enrolment: 60.
Status: Authorised, recruitment pending. Decision date: 2026-06-08. Results received: No. Last updated: 2026-06-08.

Condition(s): HIV-1 infection
Product: Microcrystalline cellulose, Dasatinib Teva 50 mg comprimidos recubiertos con película EFG

Primary endpoint: Changes in CD4, CD8, and CD56+ cell counts and activation/exhaustion markers from baseline values to 2-3 days and 24 weeks of dasatinib treatment and placebo.
Endpoint(s): Changes in CD4⁺, CD8⁺, and CD56⁺ cell counts and activation/exhaustion markers from baseline values to weeks 4, 12, 28, 36, and 48, in both the dasatinib and placebo groups., Incidence, nature and severity of adverse events during study period (clinical and laboratory)., Changes in the expression levels of CD25 and CD69 activation markers from baseline to days 2–3, and weeks 4, 12, 24, 28, 36, and 48, in both the dasatinib and placebo groups., Changes in phosphorylated SAMHD1 (Thr592) expression levels at weeks 4, 12, 24, 28, 36, and 48, in both the dasatinib and placebo groups., Characterization of the viral reservoir at weeks 4, 12, 24, 28, 36 and 48 of the study, including reservoir size and composition, reactivation capacity, integration sites, and HIV evolution and diversity., Rate of decay of the proviral reservoir during and after dasatinib treatment, as determined by a mathematical model analyzing longitudinal changes in proviral DNA levels at weeks 4, 12, 24, 28, 36 and 48., Changes in the levels of inflammation markers such as IL-6, CRP, TNFα and sCD163 during and after dasatinib treatment, assessed at weeks 4, 12, 24, 28, 36 and 48., Changes in immune exhaustion and senescence markers during and after dasatinib treatment, assessed at weeks 4, 12, 24, 28, 36 and 48., Changes in CD4+ T cell distribution and trafficking biomarkers, including CCR7, CD45RA, CD49a, CD103, CD101, CXCR6, CX3CR1, and PD-1 expression on CD69+ (tissue-resident memory T cells) and CD69- (TEM/TEMRA memory T cells), assessed at day 2-3 and weeks 4, 12, 24, 28, 36 and 48., Changes in the susceptibility of monocyte-derived macrophages to HIV-1 infection during and after dasatinib treatment, assessed at weeks 4, 12, 24, and 48 by luminescence and flow cytometry analysis of intracellular HIV-1 core protein and phosphorylated SAMHD1 (Thr592)., Changes in NK cell cytotoxic activity and activation/exhaustion markers assessed at weeks 4, 12, 24, 28, 36 and 48 by microscopy and flow cytometry.

Source: https://euclinicaltrials.eu/ctis-public/view/2025-524363-20-01